EU clinical trial 2024-510612-75-00: Efficacy and safety of once-weekly semaglutide s.c. 2.0 mg as add-on to dose-reduced insulin glargine vs titrated insuline glargine in participants with type 2 diabetes and overweight
Protocol code: NN9535-4801
Sponsor: Novo Nordisk A/S (Pharmaceutical company). Phase: Therapeutic confirmatory (Phase III). Countries: Czechia (ended), Portugal (ended), Spain (ended), Greece (ended), Slovakia (ended), Romania (ended), Italy (ended).
Therapeutic area(s): Diseases [C] - Nutritional and Metabolic Diseases [C18]
Gender: Female, Male. Age: 18-64 years, 65+ years. Enrolment: 398.
Status: Ended. Start date (EU): 2022-08-31. End date (EU): 2025-04-01. End date: 2025-04-09. Decision date: 2024-08-06. Results received: Yes. Last updated: 2025-03-12.
Decision dates by country: CZ: 2024-08-07, RO: 2024-08-12, ES: 2024-08-06, GR: 2024-08-07, IT: 2024-08-12, PT: 2024-08-06, SK: 2024-08-08

Condition(s): Participants with T2D and overweight
Product: Lantus SoloStar 100 units/ml solution for injection in a pre-filled pen, Ozempic 2 mg solution for injection in pre-filled pen, Ozempic 1 mg solution for injection in pre-filled pen

Primary endpoint: Change in HbA1c from baseline (week 0) to end of treatment (week 40)
Endpoint(s): Change in body weight from baseline (week 0) to end of treatment (week 40), Relative change in daily insulin dose from baseline (week 0) to end of treatment (week 40), Change in HbA1c From baseline (week 0) to end of treatment (week 40), Score of Diabetes Treatment Satisfaction Questionnaire – change version (DTSQc) At end of treatment (week 40)

Source: https://euclinicaltrials.eu/ctis-public/view/2024-510612-75-00